EU clinical trial 2024-511070-68-01: PRODIGE 98- AMPIRINOX : Randomized, multicenter, Phase III trial of adjuvant chemotherapy with modified FOLFIRINOX versus capecitabine or gemcitabine in patients with resected ampullary adenocarcinoma.
Protocol code: AMPIRINOX
Sponsor: Centre Hospitalier Universitaire De Dijon (Hospital/Clinic/Other health care facility). Phase: Therapeutic confirmatory (Phase III). Countries: France (ongoing, recruiting).
Therapeutic area(s): Diseases [C] - Digestive System Diseases [C06]; Diseases [C] - Neoplasms [C04]
Gender: Female, Male. Age: 18-64 years, 65+ years. Enrolment: 294.
Status: Ongoing, recruiting. Start date (EU): 2024-09-24. Decision date: 2024-09-24. Results received: No. Last updated: 2025-08-29.

Condition(s): Ampullary adenocarcinoma
Product: Capecitabine Accord 300 mg film-coated tablets, GEMCITABINE HYDROCHLORIDE, Capecitabine Accord 150 mg film-coated tablets, Capecitabine Accord 500 mg film-coated tablets, FLUOROURACIL, OXALIPLATIN, IRINOTECAN, CALCIUM FOLINATE

Primary endpoint: The primary endpoint is the 2 years Disease-free survival rate. DFS will be calculated from date of randomization to the date of first relapse (locally and/or metastatic) or date of death (all causes). Patients alive without relapse will be censored at the date of last news. Second cancer will not be considered as an event. The relapse will be assessed by the investigator according to RECIST v1.1 criteria.
Endpoint(s): OS is defined as the time between randomization and death (all causes). Patients alive will be censored at the date of last news., Rate of patients completing 3 and 6-month chemotherapy schedule according to percentage of administered dose of each product. Percentage of administrated dose will be calculated as the ratio of dose received over dose planned for each product. A completed cycle will be defined by at least 80% of each product dispensed, All grade and grade 3-4, will be described using NCI-CTCAE (National Cancer Institute – Common Terminology Criteria for Adverse Events) version 5.0, Quality of life will be assessed according to the questionnaire of EORTC QLQ-C30 and PAN26 questionnaires.

Source: https://euclinicaltrials.eu/ctis-public/view/2024-511070-68-01